EU clinical trial 2024-516127-14-01: (CHOPI) Phase 1b/2 Study Combining Hepatic Percutaneous Perfusion with Ipilimumab plus Nivolumab in advanced Uveal Melanoma.
Sponsor: Leids Universitair Medisch Centrum (LUMC) (Hospital/Clinic/Other health care facility). Phase: Phase I and Phase II (Integrated)- First administration to humans. Countries: Netherlands (ongoing, recruiting).
Therapeutic area(s): Diseases [C] - Eye Diseases [C11]; Analytical, Diagnostic and Therapeutic Techniques and Equipment [E] - Therapeutics [E02]
Gender: Female, Male. Age: 18-64 years, 65+ years. Enrolment: 88.
Status: Ongoing, recruiting. Start date (EU): 2025-01-21. Decision date: 2024-09-12. Results received: No. Last updated: 2024-09-12.

Condition(s): metastasized melonama uveal
Product: IPILIMUMAB, MELPHALAN, NIVOLUMAB

Primary endpoint: Safety and feasibility of combining percutaneous hepatic perfusion with ipilimumab and nivolumab (phase 1b part)., Efficacy as measured by progression-free survival at one year comparing PHP alone versus patients with the combination of PHP with ipilimumab and nivolumab (randomized phase 2 part).
Endpoint(s): To evaluate best overall response rate according to RECIST 1.1 and iRECIST of patients treated with PHP alone versus patients with the combination of PHP with ipilimumab and nivolumab., To evaluate overall survival of patients treated with PHP alone versus patients with the combination of PHP with ipilimumab and nivolumab.

Source: https://euclinicaltrials.eu/ctis-public/view/2024-516127-14-01